EU clinical trial 2024-514298-23-00: Exploratory Bioavailability of Three Formulations of Gliclazide MR Tablets 120 mg (I.R.I.S.) in Healthy Volunteers Under Fed Conditions (High Fat High Calorie Meal and Standard Meal).
Protocol code: S005190-213
Sponsor: Institut De Recherches Internationales Servier IRIS (Pharmaceutical company). Phase: Human Pharmacology (Phase I)- Other. Countries: Portugal (ended).
Therapeutic area(s): Not possible to specify
Gender: Female, Male. Age: 18-64 years. Enrolment: 48.
Status: Ended. Start date (EU): 2024-09-02. End date (EU): 2024-10-16. Decision date: 2024-08-30. Results received: No. Last updated: 2024-08-30.

Condition(s): No medical condicion.

Source: https://euclinicaltrials.eu/ctis-public/view/2024-514298-23-00